EU clinical trial 2024-520105-39-00: A dosimetry trial of uPAR targeted radioligand therapy in patients with glioblastoma
Protocol code: 64Cu-DOTA-AE105-201
Sponsor: Curasight A/S (Pharmaceutical company). Phase: Human Pharmacology (Phase I)- Other. Countries: Denmark (temporarily halted).
Therapeutic area(s): Diseases [C] - Nervous System Diseases [C10]
Gender: Female, Male. Age: 18-64 years, 65+ years. Enrolment: 6.
Status: Temporarily halted. Start date (EU): 2025-11-25. Decision date: 2025-08-22. Results received: No. Last updated: 2026-03-24.

Condition(s): Glioblastoma

Source: https://euclinicaltrials.eu/ctis-public/view/2024-520105-39-00